EU clinical trial 2024-514743-28-00: GeranylGeranylAcetone as prevention for postoperative Atrial Fibrillation (GENIALITY)
Protocol code: 2024-514743-28-00
Sponsor: Stichting Amsterdam UMC (Hospital/Clinic/Other health care facility). Phase: Therapeutic exploratory (Phase II). Countries: Netherlands (authorised, recruitment pending).
Therapeutic area(s): Diseases [C] - Cardiovascular Diseases [C14]
Gender: Female, Male. Age: 18-64 years. Enrolment: 146.
Status: Authorised, recruitment pending. Decision date: 2024-09-30. Results received: No. Last updated: 2025-01-21.

Condition(s): Postoperative Atrial Fibrillation
Product: Medium-chain triglycerides (Miglyol 812N), CAS Number: 73398-61-5, TEPRENONE

Primary endpoint: Assessment of Postoperative atrial fibrillation incidence, by Holter monitoring
Endpoint(s): The secondary trial endpoints are assessments of activation of HSPs by biochemical analysis and microscopic imaging; in blood, atrial tissue and epicardial adipose tissue

Source: https://euclinicaltrials.eu/ctis-public/view/2024-514743-28-00